EU clinical trial 2024-516790-78-00: Osimertinib plus chemotherapy as 1st line therapy in stage IV NSCLC patients with atypical EGFR mutations (AIO-TRK/YMO-0324)
Protocol code: FLAURARE
Sponsor: Universitat Heidelberg (Educational Institution). Phase: Therapeutic exploratory (Phase II). Countries: Germany (ongoing, recruiting).
Therapeutic area(s): Diseases [C] - Neoplasms [C04]; Diseases [C] - Respiratory Tract Diseases [C08]
Gender: Female, Male. Age: 18-64 years, 65+ years. Enrolment: 40.
Status: Ongoing, recruiting. Start date (EU): 2025-09-04. Decision date: 2025-03-24. Results received: No. Last updated: 2026-03-18.

Condition(s): stage IV NSCLC (non-small-cell lung cancer)
Product: PEMETREXED, CARBOPLATIN, CISPLATIN, TAGRISSO 40 mg film-coated tablets, TAGRISSO 80 mg film-coated tablets

Primary endpoint: Progression-free survival rate at 12 months (PFS@12) according to RECIST 1.1, defined as the proportion of patients alive with non-progressive disease 12 months after enrollment and estimated by the Kaplan-Meier method.
Endpoint(s): Progression-free survival rate (PFS), defined as time from enrollment to the date of progression according to RECIST 1.1 or death due to any cause, Overall survival (OS), defined as time from enrollment to the date of death due to any cause, Objective response rate (ORR), defined as rate of patients achieving complete response (CR) or partial response (PR) according to RECIST 1.1 as best overall response, Toxicity according to CTCAE 5.0, Progression-free survival rate (PFS2) as defined by time from initial trial randomization to second disease progression or death from any cause

Source: https://euclinicaltrials.eu/ctis-public/view/2024-516790-78-00